EU clinical trial 2024-516243-81-00: IDAR.Immediate versus delayed treatment with azathioprine or rituximab in anti-myelin oligodendrocytes glycoprotein (anti-MOG) antibodies associated acute demyelinating syndromes in children: a randomized controlled clinical trial.
Protocol code: APHP211057
Sponsor: Assistance Publique Hopitaux De Paris (Hospital/Clinic/Other health care facility). Phase: Therapeutic confirmatory (Phase III). Countries: France (ongoing, recruiting).
Therapeutic area(s): Diseases [C] - Nervous System Diseases [C10]
Gender: Female, Male. Age: 0-17 years. Enrolment: 86.
Status: Ongoing, recruiting. Start date (EU): 2025-06-23. Decision date: 2024-10-24. Results received: No. Last updated: 2024-10-24.

Condition(s): myelin oligodendrocytes glycoprotein antibody associated diseases (MOGAD)
Product: AZATHIOPRINE, METHYLPREDNISOLONE, PREDNISONE, AZATHIOPRINE, PREDNISOLONE, RITUXIMAB

Primary endpoint: The primary endpoint will be the annualized relapse rate (ARR) at 24 months.
Endpoint(s): Comparison between immediate-AZA and immediate - Annualized relapse rate at 12 and 24 months, Comparison between immediate-AZA and delayed-treatment - Annualized relapse rate at 12 and 24 months, Comparison between immediate-RTX and delayed-treatment - Annualized relapse rate at 12 and 24 months, Other clinical outcome for comparing immediate- and delayedtreatment, Radiological outcome, Immunological studies

Source: https://euclinicaltrials.eu/ctis-public/view/2024-516243-81-00